EU clinical trial 2024-516025-30-00: [18F]Tetrafluoroborate PET/CT for the Detection of Differentiated Thyroid Cancer: A Phase II Imaging Study
Sponsor: Erasmus Universitair Medisch Centrum Rotterdam (Erasmus MC) (Hospital/Clinic/Other health care facility). Phase: Therapeutic exploratory (Phase II). Countries: Netherlands (ongoing, recruiting).
Therapeutic area(s): Diseases [C] - Neoplasms [C04]
Gender: Female, Male. Age: 18-64 years, 65+ years. Enrolment: 40.
Status: Ongoing, recruiting. Start date (EU): 2025-09-01. Decision date: 2025-04-02. Results received: No. Last updated: 2025-04-02.

Condition(s): Differentiated Thyroid Cancer
Product: [18F]Tetrafluoroborate

Primary endpoint: Optimal time kinetic point and number and localization of lymph node metastases + predictive 131I therapy response, Analysis of reference standards: ultrasonography, pathology and post-therapy 131I scan (these tests are performed under regular clinical care)
Endpoint(s): To study [18F]TFB kinetics in normal thyroid tissue, in primary thyroid tumor tissue, in lymph node metastases and in distant metastases (SUVmax, tumorto-background ratio). - To analyse the possible correlation between [18F]TFB uptake and NISmembrane expression levels, as determined by immunohistochemistry. - To assess whether [18F]TFB PET/CT might be advisable especially for patients with minimally elevated tumor marker levels.

Source: https://euclinicaltrials.eu/ctis-public/view/2024-516025-30-00